EU clinical trial 2024-512766-34-00: Efficacy and Tolerance of the Combination of Methotrexate and Phototherapy Versus Phototherapy in Adults With Progressive Vitiligo: a Randomized Doubleblind Prospective Study - METVI
Protocol code: CHUBX 2017/44
Sponsor: Centre Hospitalier Universitaire De Bordeaux (Hospital/Clinic/Other health care facility). Phase: Therapeutic exploratory (Phase II). Countries: France (ended).
Therapeutic area(s): Diseases [C] - Skin and Connective Tissue Diseases [C17]
Gender: Female, Male. Age: 18-64 years, 65+ years. Enrolment: 48.
Status: Ended. Start date (EU): 2023-04-28. End date (EU): 2025-11-04. Decision date: 2024-07-19. Results received: No. Last updated: 2024-11-18.

Condition(s): Vitiligo with new lesions or extension of old lesions during the last 6 months
Product: MICROCRYSTALLINE CELLULOSE, METHOTREXATE, FOLIC ACID

Primary endpoint: Evaluation of reduction in the VASI score in the experimental group receiving MTX + UVB TL01 assessed 8 months after the start of treatment.
Endpoint(s): Evaluation of VASI score reduction at M4, Evaluation of clinical and biological measures of MTX and phototherapy safety at M4 and M8, Evaluation of VETF score variation, Evaluation of F-VASI score variation, Evaluation of F-VASI score variation, Evaluation of variation in the DLQI (Dermatology Quality of Life Index) score, Assessment of variations in blood and skin inflammatory parameters: ELISA on serum at baseline, M2, M4 and M8

Source: https://euclinicaltrials.eu/ctis-public/view/2024-512766-34-00